EU clinical trial 2024-512049-17-00: A RANDOMIZED, MULTICENTER, OPEN LABEL STUDY COMPARING TWO STANDARD TREATMENTS, BORTEZOMIB-MELPHALAN-PREDNISONE (VMP) WITH OR WITHOUT DARATUMUMAB (Dara-VMP) VS LENALIDOMIDE-DEXAMETHASONE (Rd) WITH OR WITHOUT DARATUMUMAB (Dara-Rd) IN AUTOLOGOUS STEM CELL TRANSPLANTATION (ASCT) INELIGIBLE COMMUNITY POPULATION AFFECTED BY MULTIPLE MYELOMA (MM) – Real MM
Protocol code: Real MM
Sponsor: Universita' Degli Studi Di Torino (Educational Institution). Phase: Therapeutic use (Phase IV). Countries: Italy (ongoing, recruitment ended).
Therapeutic area(s): Diseases [C] - Neoplasms [C04]
Gender: Female, Male. Age: 65+ years. Enrolment: 450.
Status: Ongoing, recruitment ended. Start date (EU): 2018-09-05. Decision date: 2024-08-07. Results received: No. Last updated: 2025-12-05.

Condition(s): Newly diagnosed MM patients >= 65 years old or ineligible for autologous stem cell transplant
Product: Revlimid 20 mg hard capsules, Revlimid 15 mg hard capsules, VELCADE 3.5 mg powder for solution for injection, Revlimid 10 mg hard capsules, DARZALEX 20 mg/mL concentrate for solution for infusion, Revlimid 2.5 mg hard capsules, ALKERAN 2 mg Compresse rivestite con film, Revlimid 25 mg hard capsules, DARZALEX 20 mg/mL concentrate for solution for infusion, Revlimid 5 mg hard capsules, SOLDESAM 0,2% gocce orali, soluzione, DARZALEX 1800 mg solution for injection, Prednisone Teva 5 mg compresse, DARZALEX 20 mg/mL concentrate for solution for infusion

Primary endpoint: PFS will be measured from the date of randomization to the date of first observation of PD, or death from any cause as an event. Subjects who withdraw from the study will be censored at the time of the last complete disease assessment. Subjects who complete the study, have not progressed, and are still alive at the cut-off date of final analysis will be censored at the cut-off date. All subjects who were lost to FU will also be censored at the time of last contact.
Endpoint(s): The rate of MRD negativity at 6 months after the start of treatment is determined as the proportion of patients with MRD negativity (≥10-5 sensitivity level) at 6 months using ITT principle. For patients who withdraw from the study or are lost to follow up before these timepoints, the best MRD assessment will be considered., The rate of MRD negativity is determined as the proportion of patients with MRD negativity by Next Generation Flow (≥10-5 sensitivity level) at 6, 12, 24-, 36-, 48- and 60-months using ITT principle. For patients who withdraw from the study or are lost to follow up before 6, 12, 24, 36, 48 and 60 months, the best MRD assessment will be considered. Patients will be classified as MRD positive if they have only MRD positive test results or do not undergo MRD assessment., ORR will include complete response (CR) and partial response (PR) using the International Response Criteria reported by Durie et al. Categories of response will include stringent CR (sCR), CR, very good partial response (VGPR), PR and PD. If, during the course of the study, other relevant categories are identified in literature, such new categories may be added. Responders are defined as subjects with at least a PR., DOR is defined as time between first documentation of response and PD. Responders without disease progression will be censored either at the time of lost to FU, at the time of death due to other cause than PD, or at the end of the study., PFS2 is defined as the time from randomization to objective tumor progression on next-line treatment or death from any cause., OS is defined as the time between randomization and death. Subjects who die will be censored at time of death as an event, regardless cause of death. Subjects who withdraw consent will be censored at the time of withdrawal. Subjects who complete the study and are still alive at the cut-off date of final analysis will be censored at the cut-off date. Subjects lost to FU will also be censored at the time of last contact., TNT will be measured from the date of randomization to the date of next anti-myeloma therapy. Death due to any cause before starting therapy will be considered an event. Subjects who withdraw consent will be censored at the time of the last complete disease assessment. Subjects who complete the study and are still alive at the cut-off date of final analysis will be censored at the cut-off date. Subjects lost to FU will also be censored at the time of last contact., TTP will be measured from the date of randomization to the date of first observation of PD, or deaths related to PD. Subjects who withdraw from the study or die from causes other than PD will be censored at the time of the last complete disease assessment. Subjects who complete the study, have not progressed, and are still alive at the cut-off date of final analysis will be censored at the cut-off date. Subjects lost to FU will also be censored at the time of last contact., Safety will be evaluated by assessing the incidence, severity and type of AEs according to NCI-CTCAE v. 4.0. and the incidence of toxicities as well as the rate of treatment discontinuation or death for toxicity will be evaluated during the entire duration of the trial., Validation of frailty score will be made by estimating efficacy and safety endpoints in patients stratified according to Myeloma Frailty Score and by considering patients’ non-Myeloma polydrug therapies., QoL will be evaluated through Health-Related QoL (HRQoL) questionnaires: EORTC-QLQ-C30 (a generic, multidimensional, cancer-specific QoL questionnaire), QLQ-MY20 (a specific 20- item MM module) and EQ-5D-5L (a generic assessment of five health categories and overall health score). After baseline visit, questionnaires should be collected every 3 months for the first year and every 6 months thereafter., Health-related costs will be reported through questionnaires. Every 3 months for the first year and every 6 months thereafter, patients or care-givers will be asked to fill out self-reported questionnaire regarding outpatient and GPs visits, emergency care, in-patient stays, home care, nursing home or residential care, care-giving, and personal use and expenditure for health related services., Infectious risk complications will be evaluated in terms of incidence, severity, type of infection, need for hospitalization, deferral or suspension of study treatment with possible impact on PFS.

Source: https://euclinicaltrials.eu/ctis-public/view/2024-512049-17-00